EU clinical trial 2024-510837-16-00: An Interventional and Translational Study investigating Sotorasib in Previously Treated Locally Advanced or Metastatic NSCLC Subjects With Mutated KRAS p.G12C (CODEBREAK)
Protocol code: 2021/3401
Sponsor: Institut Gustave Roussy (Hospital/Clinic/Other health care facility). Phase: Therapeutic exploratory (Phase II). Countries: France (ongoing, recruitment ended).
Therapeutic area(s): Diseases [C] - Neoplasms [C04]; Diseases [C] - Respiratory Tract Diseases [C08]
Gender: Female, Male. Age: 18-64 years, 65+ years. Enrolment: 40.
Status: Ongoing, recruitment ended. Start date (EU): 2022-12-13. Decision date: 2024-04-26. Results received: No. Last updated: 2026-05-11.

Condition(s): locally-advanced and unresectable or metastatic NSCLC with KRAS G12C
Product: LUMYKRAS 120 mg film-coated tablets

Primary endpoint: The clinical evaluation endpoints will be evaluated using RECIST v1.1 with the following parameters: ➢ OR is defined as the achievement of a confirmed complete response (CR) or partial response (PR) observed on treatment and assessed by investigators. Confirmation of response must be demonstrated with an assessment four weeks or later from the initial response. Treatment objective response will be radiologically assessed every eight weeks using RECIST v1.1., ➢ PFS is defined as the time from date of the first dose of sotorasib until to the earlier of the dates of the first objective documentation of progression or death from any cause, whichever occurs first. At the time of analysis, the patient alive and without progression will be censored at the date of the last tumor assessment., ➢ OS is defined as the time from date of the first sotorasib dose until death. Patients alive at last follow-up will be censored.
Endpoint(s): Co-mutations, mutational signatures and TMB at baseline;, Acquired mutations under treatment and at treatment progression;, Mutation status and proteic changes on viable patient-derived xenografts models;, Immune phenotype status at baseline, under treatment and at time of progression;, Transcriptomic signatures at baseline, under treatment and at time of progression.

Source: https://euclinicaltrials.eu/ctis-public/view/2024-510837-16-00